EU clinical trial 2024-511358-36-00: Selective Bladder-Sparing Trial with Sasanlimab as Maintenance Treatment Based On Clinical Response To Neoadjuvant Treatment In Molecularly Categorized Muscle Invasive Bladder Cancer Patients
Protocol code: HM-87884561
Sponsor: Fundacion De investigacion De Hm Hospitales (Hospital/Clinic/Other health care facility). Phase: Therapeutic exploratory (Phase II). Countries: Spain (ongoing, recruitment ended).
Therapeutic area(s): Diseases [C] - Neoplasms [C04]
Gender: Female, Male. Age: 18-64 years, 65+ years. Enrolment: 70.
Status: Ongoing, recruitment ended. Start date (EU): 2024-11-11. Decision date: 2024-07-29. Results received: No. Last updated: 2026-02-12.

Condition(s): Molecularly Categorized Muscle Invasive Bladder Cancer
Product: Sasanlimab, PF-06801591

Primary endpoint: The primary endpoint will be the bladder-intact overall survival rate at 12 months after the first dose of sasanlimab. Bladder-intact overall survival is defined as the time from initiation of sasanlimab treatment until death or cystectomy. The primary endpoint will be the percentage of patients who are alive and with no cystectomy at 12 months after the first dose of sasanlimab.
Endpoint(s): Secondary Efficacy Endpoints ● Clinical response rate, defined as absence of muscle-invasive cancer after cisplatin-based treatment (≤cT1). ● Disease-free survival (DFS) according to Section 8.1. ● Metastasis-free survival (MFS) according to RECIST v1.1 (Appendix 3). ●Overall survival (OS). ● Health-related quality of life (HRQoL), assessed through the European Organization for Research and Treatment of Cancer Quality of Life Questionnaire C30 (EORTC QLQ-C30) version 3 (Appendix 4)., Secondary Safety Endpoints ●Frequency and severity of adverse events and treatment-related adverse events (TRAEs) assessed by NCI CTCAE v5.0 (Appendix 5). ● Frequency of AEs leading to treatment discontinuation., Secondary Exploratory Endpoints: ● Correlation of baseline ctDNA levels with efficacy endpoints. ● Correlation between tumor markers from TURBT biopsy at baseline and benefit of maintenance treatment with sasanlimab. ●Changes in ctDNA levels in blood samples throughout the study treatment period.

Source: https://euclinicaltrials.eu/ctis-public/view/2024-511358-36-00